EU clinical trial 2023-504815-34-00: A single dose, randomized, open-label, three-way crossover study to assess bioequivalence of paracetamol orodispersible tablets 500 mg vs Apiretal® 100 mg/ml oral solution in healthy volunteers under fasting conditions
Protocol code: BESPA-ODT
Sponsor: Laboratorios Ern S.A. (Pharmaceutical company). Phase: Human Pharmacology (Phase I)- Bioequivalence Study. Countries: Spain (ended).
Therapeutic area(s): Not possible to specify
Gender: Female, Male. Age: 18-64 years. Enrolment: 24.
Status: Ended. Start date (EU): 2023-10-30. End date (EU): 2023-12-18. Decision date: 2023-10-09. Results received: Yes. Last updated: 2023-10-09.

Condition(s): Healthy volunteers under fasting conditions
Product: apiretal 500 mg comprimidos bucodispersables, Apiretal 100 mg/ml solución oral

Primary endpoint: · AUC0-t: Area under the plasma concentration-time curve from administration (t = 0) to the last observed concentration at time t (where t is the last time point with a measurable concentration) calculated according to the linear trapezoidal rule. · Cmax: Observed maximum plasma concentration (peak exposure).
Endpoint(s): Secondary endpoints of bioavailability evaluated after the administration of a single dose will be: AUC0-∞, tmax, t1/2, lz, CL/F, V/F of paracetamol. Variables obtained in the safety evaluations will be also evaluated: adverse events recordings, vital signs, laboratory tests and ECG recordings.

Source: https://euclinicaltrials.eu/ctis-public/view/2023-504815-34-00